EU clinical trial 2024-515129-27-00: Assess efficacy of intra-arterial autologous myogenic stam cell therapy for m.3243A>G mutation carriers
Sponsor: Academisch Ziekenhuis Maastricht (Hospital/Clinic/Other health care facility). Phase: Phase I and Phase II (Integrated)- First administration to humans. Countries: Netherlands (authorised, recruitment pending).
Therapeutic area(s): Diseases [C] - Nutritional and Metabolic Diseases [C18]; Diseases [C] - Musculoskeletal Diseases [C05]; Phenomena and Processes [G] - Genetic Phenomena [G05]
Gender: Female, Male. Age: 18-64 years. Enrolment: 20.
Status: Authorised, recruitment pending. Decision date: 2024-11-19. Results received: No. Last updated: 2026-02-26.

Condition(s): m.3243A>G mutation causing mitochondrial myopathy
Product: Autologous mesoangioblasts

Primary endpoint: Assessment of safety parameters (angiography, 8h post-procedure monitoring of neurological vital signs, (S)AE) and assessment of changes in muscle strength and muscle fatigue of treated and untreated biceps brachii muscle using Biodex dynamometer measurements at baseline and 4-6 weeks after the third ATMP administration.
Endpoint(s): Assess muscle mass, morphology, m.3243A>G mutation load and mitochondrial respiratory capacity in muscle biopsies of treated BB muscle

Source: https://euclinicaltrials.eu/ctis-public/view/2024-515129-27-00